EU clinical trial 2023-506227-29-00: A Phase 1 Open-Label Study to Evaluate the Efficacy and Safety of ABBV-400 in Select Advanced Solid Tumor Indications
Protocol code: M24-427
Sponsor: AbbVie Deutschland GmbH & Co. KG (Pharmaceutical company). Phase: Human Pharmacology (Phase I)- Other. Countries: Spain (ongoing, recruiting), France (not authorised).
Therapeutic area(s): Diseases [C] - Neoplasms [C04]
Gender: Female, Male. Age: 18-64 years, 65+ years. Enrolment: 60.
Start date (EU): 2024-08-30. Decision date: 2024-07-29. Results received: No. Last updated: 2026-07-13.
Decision dates by country: FR: 2024-07-29, ES: 2024-07-30

Condition(s): locally advanced or metastatic solid tumors

Source: https://euclinicaltrials.eu/ctis-public/view/2023-506227-29-00